EU clinical trial 2024-513616-95-00: A Phase 2/3, Multicenter Randomized Study of Rituximab-Gemcitabine- Dexamethasone-Platinum (R-GDP) With or Without Selinexor in Patients with Relapsed/Refractory Diffuse Large B-Cell Lymphoma (RR DLBCL).
Protocol code: XPORT-DLBCL-30
Sponsor: Karyopharm Therapeutics Inc. (Pharmaceutical company). Phase: Phase II and Phase III (Integrated). Countries: Poland (ended), Spain (ended), Italy (ongoing, recruitment ended).
Therapeutic area(s): Diseases [C] - Hemic and Lymphatic Diseases [C15]; Diseases [C] - Neoplasms [C04]
Gender: Female, Male. Age: 18-64 years, 65+ years. Enrolment: 60.
Start date (EU): 2020-12-22. Decision date: 2024-11-07. Results received: No. Last updated: 2026-04-24.
Decision dates by country: IT: 2024-11-12, ES: 2024-11-07, PL: 2024-11-08

Condition(s): Relapsed/Refractory Diffuse Large B-Cell Lymphoma (RR DLBCL)
Product: Ondansetron Aurobindo 8 mg Filmtabletten, Zarzio 48 MU/0.5 ml solution for injection or infusion in pre-filled syringe, Rixathon 500 mg concentrate for solution for infusion, Zarzio 48 MU/0.5 ml solution for injection or infusion in pre-filled syringe, Rixathon 500 mg concentrate for solution for infusion, Cisplatin 1 mg/ml Concentrate for Solution for Infusion, Dexametazona Krka 4 mg comprimate, EMEND 125 mg+80 mg hard capsules, Carboplatin Hikma 10 mg/ml Konzentrat zur Herstellung einer Infusionslösung, Gemcitabine 2 g Powder for Solution for Infusion, Selinexor placebo for 20 mg tablets is formulated for oral administration. Selinexor placebo tablets are film coated bi-convex round tablets, Zarzio 48 MU/0.5 ml solution for injection or infusion in pre-filled syringe, SELINEXOR, Zarzio 48 MU/0.5 ml solution for injection or infusion in pre-filled syringe

Primary endpoint: Phase 2: overall response rate (ORR) based on the Lugano Classification 2014., Phase 3: Progression-free survival (PFS) based on the Lugano Classification 2014
Endpoint(s): Phase 2: Progression-free survival (PFS) based on the Lugano Classification 2014. Overall survival, Phase 3: overall response rate (ORR) based on the Lugano Classification 2014. Overall survival.

Source: https://euclinicaltrials.eu/ctis-public/view/2024-513616-95-00